EU clinical trial 2023-507481-43-00: Evaluation of the omission of dexamethasone in premedication regimens during paclitaxel treatment
Sponsor: Erasmus Universitair Medisch Centrum Rotterdam (Erasmus MC) (Hospital/Clinic/Other health care facility). Phase: Phase III and phase IV (Integrated). Countries: Netherlands (authorised, recruiting).
Therapeutic area(s): Diseases [C] - Neoplasms [C04]
Gender: Female, Male. Age: 18-64 years, 65+ years. Enrolment: 500.
Status: Authorised, recruiting. Start date (EU): 2024-06-25. Decision date: 2024-02-19. Results received: No. Last updated: 2026-05-26.

Condition(s): Solid tumors
Product: Dexamethasone 4 mg tablets, Dexamethasone Phosphate 4 mg/ml Solution for Injection

Primary endpoint: The primary outcome is the percentage of patients who experience a clinically relevant HSR (CTCAE grade ≥3) during paclitaxel infusion (Yes/No), determined prospectively by the oncology medical staff (e.g. oncologist).
Endpoint(s): The incidence of the HSRs (all grades) as defined by (CTCAE v.5.0);, The severity (grades) of all HSRs as defined by (CTCAE v.5.0);, The percentage (%) of patients that can be rechallenged (according to standard of care procedures) after the occurrence of an HSR with or without dexamethasone;, The number of paclitaxel administrations and cumulative dose (mg) until the first HSR occurrence., The incidence and severity of adverse events related to dexamethasone measured through the validated Dexamethasone Symptom Questionnaire (DSQ)21;, The patient quality of life measured using the EuroQol-5 dimensions-5 levels (EQ-5D-5L) and European Organization for the Research and Treatment of Cancer Quality of Life Questionnaire (EORTC QLQ C-30) scorings tools);, The total cost of treatment of both premedication regimens from a healthcare and societal perspective.

Source: https://euclinicaltrials.eu/ctis-public/view/2023-507481-43-00